EU clinical trial 2024-517987-46-00: A multicentre, randomised, double-blind, placebo-controlled, parallel-group trial to evaluate the efficacy and safety of BP1.4979 in adult patients with essential tremor
Protocol code: P23-05
Sponsor: Bioprojet Pharma (Pharmaceutical company). Phase: Therapeutic exploratory (Phase II). Countries: France (ongoing, recruitment ended).
Therapeutic area(s): Diseases [C] - Nervous System Diseases [C10]
Gender: Female, Male. Age: 18-64 years, 65+ years. Enrolment: 50.
Status: Ongoing, recruitment ended. Start date (EU): 2025-07-21. Decision date: 2025-06-13. Results received: No. Last updated: 2026-06-26.

Condition(s): Essential tremor
Product: Matches test product

Primary endpoint: The primary efficacy endpoint is the change in the total score of the Performance Subscale of The Essential Tremor Rating Assessment Scale (TETRAS-P) after 4 weeks of treatment.
Endpoint(s): No secondary endpoints are planned in this trial.

Source: https://euclinicaltrials.eu/ctis-public/view/2024-517987-46-00